EU clinical trial 2024-517623-39-00: An Open-label, Multicenter Study to Evaluate the Long-term Safety and Efficacy of Ulviprubart (ABC008) in Subjects Who Have Completed a Trial of Ulviprubart for the Treatment of Inclusion Body Myositis
Protocol code: ABC008-IBM-202
Sponsor: Abcuro Inc. (Pharmaceutical company). Phase: Therapeutic confirmatory (Phase III). Countries: Germany (ended), Belgium (ended), France (ended).
Therapeutic area(s): Diseases [C] - Musculoskeletal Diseases [C05]
Gender: Female, Male. Age: 18-64 years, 65+ years. Enrolment: 13.
Status: Ended. Start date (EU): 2025-08-25. End date (EU): 2026-06-11. End date: 2026-06-12. Decision date: 2025-04-11. Results received: No. Last updated: 2026-03-12.
Decision dates by country: BE: 2025-04-11, FR: 2025-04-11, DE: 2025-04-16

Condition(s): inclusion body myositis
Product: Ulviprubart

Primary endpoint: The primary endpoint for the study will be the incidence, type, and severity of treatment-emergent adverse events (TEAEs).
Endpoint(s): Safety:Incidence, type, and severity of treatment-emergent serious adverse events (TESAEs), Safety: Incidence of TEAEs leading to study medication or study discontinuation, Safety: Clinically significant changes in standard laboratory parameters and vital signs, Safety: Adverse events of special interest (AESIs),, Efficacy: Mean change from Baseline (Day 1) in IBMFRS over the duration of the study., Efficacy: Mean change from Baseline (Day 1) in MMT 12 over the duration of the study

Source: https://euclinicaltrials.eu/ctis-public/view/2024-517623-39-00